EU clinical trial 2023-509784-24-00: A Phase 2b Randomized, Double-blind, Placebo-controlled, Repeat-dose, Multicenter Trial to Evaluate the Efficacy, Safety and Tolerability of HZN-825 in Subjects with Idiopathic Pulmonary Fibrosis
Protocol code: HZNP-HZN-825-303
Sponsor: Horizon Therapeutics Ireland Designated Activity Company (Pharmaceutical company). Phase: Therapeutic exploratory (Phase II). Countries: France (ended), Poland (ended), Netherlands (ended), Italy (ended), Spain (ended), Greece (ended).
Therapeutic area(s): Diseases [C] - Respiratory Tract Diseases [C08]
Gender: Female, Male. Age: 18-64 years, 65+ years. Enrolment: 17.
Status: Ended. Start date (EU): 2022-05-11. End date (EU): 2024-10-30. End date: 2025-01-02. Decision date: 2024-05-22. Results received: Yes. Last updated: 2024-12-18.
Decision dates by country: ES: 2024-05-22, FR: 2024-05-24, IT: 2024-05-28, NL: 2024-06-07, PL: 2024-05-27, GR: 2024-06-26

Condition(s): Idiopathic Pulmonary Fibrosis
Product: Fipaxalparant, Film-coated tablet, Major Ingredients Mannitol, microcrystalline cellulose, magnesium stearate, polyvinyl alcohol, macrogol, titanium dioxide and talc

Primary endpoint: Core Phase: Change in FVC % predicted from Baseline to Week 52. Extension Phase: Change from both Baselines in FVC % predicted at Week 104.
Endpoint(s): Core Phase: 1. Proportion of subjects with decline in FVC % predicted ≥10% from Baseline at Week 52. 2. Change from Baseline in the 6MWT results to Week 52. 3. Change from Baseline in K-BILD scores to Week 52. 4. Change from Baseline in L-IPF scores to Week 52. 5. Change from Baseline in LCQ scores to Week 52. Please refer to protocol section 8.1.2 and 8.2.2 for details

Source: https://euclinicaltrials.eu/ctis-public/view/2023-509784-24-00